EU clinical trial 2024-511915-21-01: Treatment of advanced or metastatic triple negative breast cancer with tumor infiltrating lymphocytes (TILs).
Protocol code: The TILS001 trial
Sponsor: Fundacio De Recerca Clinic Barcelona-Institut D’Investigacions Biomediques August Pi I Sunyer (Laboratory/Research/Testing facility). Phase: Human Pharmacology (Phase I)- First administration to humans. Countries: Spain (ongoing, recruiting).
Therapeutic area(s): Diseases [C] - Neoplasms [C04]
Gender: Female, Male. Age: 18-64 years, 65+ years. Enrolment: 20.
Status: Ongoing, recruiting. Start date (EU): 2025-05-05. Decision date: 2024-06-20. Results received: No. Last updated: 2025-10-20.

Condition(s): advanced or metastasic triple-negative breast cancer

Source: https://euclinicaltrials.eu/ctis-public/view/2024-511915-21-01